EU clinical trial 2024-518658-18-00: Phase II, Multicenter Study to Assess Safety and Efficacy of Combination of Sargramostim with D-VCd Therapy (Daratumumab, Cyclophosphamide, Bortezomib, Dexamethasone) in Untreated Patients with Light Chain Amyloidosis
Protocol code: STARLIGHT
Sponsor: Medical University Of Warsaw (Educational Institution). Phase: Therapeutic exploratory (Phase II). Countries: Poland (ongoing, recruitment ended).
Therapeutic area(s): Diseases [C] - Neoplasms [C04]
Gender: Female, Male. Age: 18-64 years, 65+ years. Enrolment: 20.
Status: Ongoing, recruitment ended. Start date (EU): 2023-07-26. Decision date: 2024-12-16. Results received: No. Last updated: 2025-09-11.

Condition(s): Light chain amyloidosis (AL amyloidosis) is an incurable plasma cell neoplasm and the most common among a heterogeneous group of over 30 rare and ultra-rare diseases known as amyloidoses. In AL amyloidosis the deposition of amyloid fibrils resulting from misfolded immunoglobulin light chains leads to end-stage failure of the affected organs, most often of the heart or kidneys. Current therapy of AL amyloidosis is based on the destruction of clonal plasma cells with chemotherapy or immunotherapy, which leads to the inhibition of the production of immunoglobulin light chains, which are the precursors of amyloid. Effective inhibition of amyloid production enables slow resorption of already formed deposits, which results in organ responses in some patients. In vitro and in vivo studies showed amyloid deposits removal via phagocytosis by macrophages and neutrophils.So far, no therapies have been approved that would directly affect the amyloid deposits, however, clinical trials with opsonizing antibodies are ongoing,he mechanism of which is binding and neutralization of amyloid deposits in the process of phagocytosis. In 2021, based on the results of the ANDROMEDA phase III clinical trial, the most effective therapy for AL amyloidosis was registered so far: the D-VCD regimen combining anti-CD38 monoclonal antibody, daratumumab, with standard chemotherapy bortezomib, cyclophosphamide and dexamethasone. The recombinant granulocyte macrophage colony stimulating factor (GM-CSF) sargramostim will be used in this study with the D-VCD regimen. Currently, the indication for its use in the USA includes mobilization of progenitor cells and support for the reconstruction of white blood cells after autologous bone marrow transplantation, induction treatment of acute myeloid leukemia and myelosuppressive radiation.In patients with rheumatoid arthritis, a relationship between high levels of GM-CSF in the synovial fluid and a lower risk of developing Alzheimer's disease, which is associated with the accumulation of amyloid beta deposits in the brain, has been observed. In studies in a transgenic mouse model, it was shown that injections of GM-CSF led to a rapid reduction in the amount of beta amyloid in the brain and to neurological improvement. In a recent clinical trial in patients with Alzheimer's disease, a 3-week treatment with sargramostim resulted in improved cognitive function, decrease plasma markers of neurodegeneration and increase of amyloid beta (decreased in AD) compared to placebo. We assume that activation of tissue phagocytes thanks to the use of sargramostim will result in more effective phagocytosis of amyloid deposits, which, together with the active destruction of clonal plasma cells by D-VCd immunochemotherapy, may lead to an increase in the frequency of organ responses.
Product: VELCADE 3.5 mg powder for solution for injection, Dexamethasone Krka, 4 mg/ml, roztwór do wstrzykiwań/do infuzji, DARZALEX 1800 mg solution for injection, Dexamethasone Krka, 20 mg, tabletki, Endoxan 200 mg pulbere pentru solutie perfuzabila/injectabila, Endoxan® „Baxter“ 50 mg - Dragees, VELCADE 1 mg powder for solution for injection

Primary endpoint: Complete hematologic response rate (CHRR) (from the first response evaluation to the end of combination treatment (EOCT) assessment), Serious adverse events rate (measured from the date of informed consent form is signed to the EOCT assessment)
Endpoint(s): Overall hematologic response rate (OHRR) (from the first response evaluation to the EOCT assessment), Organ response rate (OrRR) for heart, kidney, liver (from the first response evaluation to the last assessment), Minimal residual disease (MRD) status (measured at the time CHR is assessed), Hematologic progression free survival (PFS) (measured from C1D1 to the date of first documentation of hematologic progression, or death due to any cause, whichever occurs first)

Source: https://euclinicaltrials.eu/ctis-public/view/2024-518658-18-00